EU clinical trial 2023-505961-10-00: Effect of mesenchymal stem cells on healing of foot ulcers in diabetes patients. A phase I pilot study.
Protocol code: STEMFOOT
Sponsor: Cell2cure ApS (Pharmaceutical company). Phase: Phase I and Phase II (Integrated)- Other. Countries: Denmark (ended).
Therapeutic area(s): Diseases [C] - Skin and Connective Tissue Diseases [C17]
Gender: Female, Male. Age: 18-64 years, 65+ years. Enrolment: 30.
Status: Ended. Start date (EU): 2022-12-15. End date (EU): 2025-11-28. Decision date: 2023-07-10. Results received: No. Last updated: 2025-06-06.

Condition(s): Diabetic foot ulcus

Source: https://euclinicaltrials.eu/ctis-public/view/2023-505961-10-00